EU clinical trial 2024-514550-73-00: Intravenous dexmedetomidine as an adjuvant to locoregional anesthesia in pediatric surgery: a prospective, randomized, double-blind, placebo-controlled study. DEXPED
Protocol code: RECHMPL23_0433
Sponsor: Centre Hospitalier Universitaire De Montpellier (Hospital/Clinic/Other health care facility). Phase: Therapeutic exploratory (Phase II). Countries: France (ongoing, recruiting).
Therapeutic area(s): Analytical, Diagnostic and Therapeutic Techniques and Equipment [E] - Anesthesia and Analgesia [E03]; Analytical,Diagnostic,Therapeutic Techniques and Equipment [E]-Surgical Procedures, Operative [E04]
Gender: Female, Male. Age: 0-17 years. Enrolment: 200.
Status: Ongoing, recruiting. Start date (EU): 2025-02-03. Decision date: 2024-11-05. Results received: No. Last updated: 2026-01-23.

Condition(s): Loco-regional anesthesia in pediatric surgery
Product: DEXMEDETOMIDINE, SODIUM CHLORIDE

Primary endpoint: Number of patients using a rescue analgesic (Nalbuphine, Nubain®) in the PACU between the two arms
Endpoint(s): Assessment of postoperative pain using the Face Legs Activity Cry Consolability (FLACC) scale: on admission and every 15 minutes until discharge from the PACU, then before returning home, Intraoperative morphine consumption: Sufentanil, number of re-injections (0.1 µg/kg) required, Dose in milligrams of emergency analgesics in the PACU, Incidence of opioid-related side effects (respiratory complications, postoperative nausea and vomiting), Length of stay (from PACU entry to discharge based on Aldrete score > 9), Incidence of emergence delirium in the PACU according to the Pediatric Anesthesia Emergence Delirium (PAED) scale, Post-Hospitalization Behavior Questionnaire at 7 days, 3, and 6 months, Postoperative Pain Measure For Parents at 7 days, 3, and 6 months, Post-operative quality of life questionnaire pedsQL at 7 days, 3 and 6 months

Source: https://euclinicaltrials.eu/ctis-public/view/2024-514550-73-00